EU clinical trial 2024-517942-33-03: A multi-center phase 3 study of 18F-florbetaben positron emission tomography/computed tomography (PET-CT) to non-invasively diagnose cardiac AL amyloidosis: the PETAL study.
Protocol code: PETAL
Sponsor: Fondazione Toscana Gabriele Monasterio (Patient organisation/association). Phase: Therapeutic confirmatory (Phase III). Countries: Italy (ongoing, recruiting).
Therapeutic area(s): Diseases [C] - Cardiovascular Diseases [C14]
Gender: Female, Male. Age: 18-64 years, 65+ years. Enrolment: 150.
Status: Ongoing, recruiting. Start date (EU): 2023-02-04. Decision date: 2025-01-21. Results received: No. Last updated: 2025-01-21.

Condition(s): cardiac amyloidosis
Product: Neuraceq 300 MBq/mL solution for injection

Primary endpoint: Concordance (with 95% confidence interval) of two pathways for diagnosing AL-CA in patients with a monoclonal component: the traditional (invasive) pathway and a noninvasive pathway using 18F-florbetaben PET/CT (visual evaluation).
Endpoint(s): Sensitivity, specificity, positive and negative predictive value of PET/CT with 18Fflorbetaben (visual evaluation) to diagnose AL-CA compared with the current diagnostic standard., Cut-off di esclusione o di conferma diagnostica di AC tipo AL dalla PET/TC con 18Fflorbetaben (analisi quantitativa) tra i pazienti con sospetto di AC e componente monoclonale;, Variation in the intensity of myocardial uptake of 18F-florbetaben over 12 months in relation to clinical and instrumental variables, safety and tolerability of PET/CT with 18Fflorbetaben in patients in patients with a monoclonal component, assessed in terms of adverse events during the imaging procedure and in the days immediately following

Source: https://euclinicaltrials.eu/ctis-public/view/2024-517942-33-03